EU clinical trial 2024-517018-14-00: A randomized multicenter Phase II trial evaluating oral pooled fecal microbiotherapy (MaaT033) concomitant to Cemiplimab (CB) versus best investigator’s choice (BIC) in resistance to PD-1/PD-L1 blockade due to antibiotics (ATB) uptake in patients with advanced non-small cell lung cancer (NSCLC) - IMMUNOLIFE2
Protocol code: 2024/3967
Sponsor: Institut Gustave Roussy (Hospital/Clinic/Other health care facility). Phase: Therapeutic exploratory (Phase II). Countries: France (ongoing, recruiting).
Therapeutic area(s): Diseases [C] - Neoplasms [C04]; Diseases [C] - Respiratory Tract Diseases [C08]
Gender: Female, Male. Age: 18-64 years. Enrolment: 162.
Status: Ongoing, recruiting. Start date (EU): 2025-11-17. Decision date: 2025-04-11. Results received: No. Last updated: 2026-06-15.

Condition(s): Advanced non-small cell lung cancer
Product: VINORELBINE, CISPLATIN, MaaT033, CARBOPLATIN, PACLITAXEL, VINORELBINE, GEMCITABINE, PEMETREXED, PACLITAXEL, CARBOPLATIN, PEMETREXED, CISPLATIN, CARBOPLATIN, CISPLATIN, DOCETAXEL, CISPLATIN, DOCETAXEL, DOCETAXEL, LIBTAYO 350 mg concentrate for solution for infusion., GEMCITABINE, BEVACIZUMAB, GEMCITABINE, VINORELBINE, PACLITAXEL, PEMETREXED, PACLITAXEL, PEMETREXED, BEVACIZUMAB, PEMETREXED, GEMCITABINE, PEMETREXED, PEMETREXED, CARBOPLATIN, DOCETAXEL, PACLITAXEL, VINORELBINE, PEMETREXED

Primary endpoint: To evaluate whether combination of MaaT033 and CB can enhance DCR at weeks 12 as per the RECIST 1.1 criteria compared to BIC. The DCR is defined as the percentage of patients achieving complete response (CR), partial response (PR) or stable disease (SD) using RECIST v1.1 criteria. Confirmation of response must be demonstrated with an assessment 4-8 weeks from the initial response assessment (iRECIST).
Endpoint(s): To evaluate Whether combination of MaaT033 and CB can increase DCR/ORR at 12, 24, 36 and 60 months. The ORR is defined as the rate of CR or PR as per the Response Evaluation Criteria in Solid Tumors version 1.1 (RECIST v1.1) criteria, To evaluate whether combination of MaaT033 and CB can increase PFS. The PFS is defined as the time from random assignment to the progression, or death due to any cause, whichever occurs first., To evaluate whether combination of MaaT033 and CB can increase OS. The OS is defined as the time from random assignment to the date of death due to any cause, or to the date of censoring at the last time the subject was known to be alive, Whether combination of MaaT033 and CB can increase the DoR. The DoR is defined as the time from the first confirmed patient response (CR or PR) to disease progression (or death from any cause)., Incidence of AEs, treatment-emergent AEs (TEAEs), serious AEs (SAEs), death, and laboratory abnormalities related to MaaT033 and CB versus BIC, using the National Cancer Institute-Common Terminology Criteria for AEs (NCI-CTCAE) v5.0. Safety parameters include all SAEs or non-serious adverse events (AEs) and deaths graded using the NCI-CTCAE v5.0 (Common Terminology Criteria for AEs)., To evaluate the effect(s) of the combination of MaaT033 and CB versus BIC on the composition of gut microbiota, on blood inflammation parameters, on systemic and tumor immunity (blood and tumor deposits), and on systemic and gut metabolism at baseline prior to 1st dose of MaaT033, prior to first dose of CB, at weeks 12 and 24 during treatment period, and again at months 12 and 24 after randomization., To identify pathophysiological surrogates of a successful MaaT033 and restoration of the ORR among a rich multi-omics database (metagenomics, metabolomics, immunomics/inflammation, epithelial/endothelial barrier markers).

Source: https://euclinicaltrials.eu/ctis-public/view/2024-517018-14-00